EU clinical trial 2023-509302-30-00: Double-Blind, Placebo-Controlled, Phase 3 Study to Evaluate the Efficacy and Safety of Plozasiran in Adults with Hypertriglyceridemia (MUIR-3 Study)
Protocol code: AROAPOC3-3009
Sponsor: Arrowhead Pharmaceuticals Inc. (Pharmaceutical company). Phase: Therapeutic confirmatory (Phase III). Countries: Slovakia (ongoing, recruitment ended), France (ended), Czechia (ongoing, recruitment ended), Spain (ongoing, recruitment ended), Germany (ongoing, recruitment ended), Bulgaria (ongoing, recruitment ended), Hungary (ongoing, recruitment ended), Poland (ongoing, recruitment ended), Italy (ended).
Therapeutic area(s): Diseases [C] - Nutritional and Metabolic Diseases [C18]
Gender: Female, Male. Age: 18-64 years, 65+ years. Enrolment: 478.
Start date (EU): 2024-11-04. Decision date: 2024-10-07. Results received: No. Last updated: 2026-06-04.
Decision dates by country: DE: 2024-10-08, HU: 2024-10-09, FR: 2024-10-08, IT: 2024-10-14, PL: 2024-10-13, SK: 2024-10-07, ES: 2024-10-08, CZ: 2024-10-11, BG: 2024-10-10

Condition(s): Hypertriglyceridemia
Product: ARO-APOC3 PFS, Plozasiran Injection Placebo

Primary endpoint: Percent change in fasting serum TG levels from baseline to Month 12 (V10 and V11) compared to placebo
Endpoint(s): Percent change in fasting serum TG levels from baseline to Month 10 (V8 and V9) compared to placebo, Proportion of subjects who achieve fasting TG levels of <150 mg/dL (<1.69 mmol/L) at Month 12 (V10 and V11) compared to placebo, Percent change in remnant cholesterol (VLDL-C) from baseline to Month 12 (V11) compared to placebo, Percent change in non-HDL-C from baseline to Month 12 (V11) compared to placebo

Source: https://euclinicaltrials.eu/ctis-public/view/2023-509302-30-00